EU clinical trial 2024-519105-35-00: Single-arm, open-label dose titration phase 2 clinical trial of (+)-α-DHTBZ for the treatment of tardive dyskinesia (TD)
Protocol code: 2022-01
Sponsor: Adeptio Pharmaceuticals Limited (Pharmaceutical company). Phase: Therapeutic exploratory (Phase II). Countries: Croatia (temporarily halted).
Therapeutic area(s): Diseases [C] - Nervous System Diseases [C10]
Gender: Female, Male. Age: 18-64 years, 65+ years. Enrolment: 6.
Status: Temporarily halted. Start date (EU): 2023-08-23. Decision date: 2025-01-28. Results received: No. Last updated: 2025-01-28.

Condition(s): tardive dyskinesia
Product: (+)-α-DIHYDROTETRABENAZINE

Primary endpoint: AIMS Dyskinesia Total Score at week 8 compared to baseline. Severity of TD symptoms assessed by AIMS dyskinesia total score, as assessed by investigators. The AIMS Total Dyskinesia Score rates a total of 7 items, rating involuntary movement from 0 to 4. Items 1 through 7 include facial and oral movements, extremity movements, and trunk movements. The total score for Items 1-7 ranges from 0 to 28; a higher score reflects increased severity., An exploratory central blinded AIMS video rating will also be performed in 50% of patients per site at baseline and week 8, on basis of voluntary agreement, to assess the degree of concordance of measurements and feasibility for future clinical development, Safety: Number of Participants with Adverse Events following dosing with (+)-α-DHTBZ. Outcome assessment includes monitoring of: o Nature and frequency of clinical adverse events o Clinical laboratory tests o Vital signs o Physical examinations o 12-lead ECG o Changes from baseline in tests of psychiatric symptoms and cognitive function
Endpoint(s): AIMS Dyskinesia Total Score at weeks specified in the SoA compared to baseline, Clinical Global Impression of Tardive Dyskinesia (CGI-TD) at weeks specified in the SoA compared to baseline. Clinician's perspective of the participant's overall improvement of TD symptoms over time. The CGI-TD is based on a 7-point scale (range: 1=very much improved to 7=very much worse)., Calgary Depression Scale for Schizophrenia (CDSS) at weeks specified in the SoA compared to baseline. The Calgary Depression Scale for Schizophrenia (CDSS) is a nine-item structured interview scale that was designed in 1990 specifically to assess depression independently of symptoms of psychosis in schizophrenia., C-SSRS at weeks specified in the SoA compared to baseline. It rates an individual's degree of suicidal ideation on a scale, ranging from "wish to be dead" to "active suicidal ideation with specific plan and intent and behaviors." The scale identifies specific behaviors which may be indicative of an individual's intent to complete suicide. An individual exhibiting even a single behavior identified by the scale was 8 to 10 times more likely to complete suicide, Positive and Negative Syndrome Scale (PANSS) at weeks specified in the SoA compared to baseline. It is a scale used for measuring symptom severity of patients with schizophrenia, The University of California, San Diego Brief Assessment of Capacity to Consent (UBACC) at weeks specified in the SoA compared to baseline. A test for assessing decisional capacity for clinical research, Pharmacokinetics. Plasma samples will be collected at the end of weeks 2, 4, 6, 8 and 2 weeks after the last dose of the study drug (or early termination) for determination of plasma concentrations of (+)- α-DHTBZ, to assess treatment compliance

Source: https://euclinicaltrials.eu/ctis-public/view/2024-519105-35-00